EU clinical trial 2023-506950-18-00: Mesotherapy treatment of irritable bowel syndrome
Protocol code: MESOCOLO
Sponsor: Polyclinique De L'europe (Hospital/Clinic/Other health care facility). Phase: Therapeutic exploratory (Phase II). Countries: France (authorised, recruitment pending).
Therapeutic area(s): Diseases [C] - Digestive System Diseases [C06]
Gender: Female, Male. Age: 18-64 years, 65+ years. Enrolment: 27.
Status: Authorised, recruitment pending. Decision date: 2024-02-08. Results received: No. Last updated: 2024-02-08.

Condition(s): Irritable bowel syndrome

Source: https://euclinicaltrials.eu/ctis-public/view/2023-506950-18-00